EU clinical trial 2024-511934-11-00: A randomized, open-label, multi-arm, two-part, phase II study to assess the efficacy and safety of multiple LXH254 combinations in patients with previously treated unresectable or metastatic BRAFV600 or NRAS mutant melanoma
Protocol code: CLXH254C12201
Sponsor: Novartis Pharma AG (Pharmaceutical company). Phase: Therapeutic exploratory (Phase II). Countries: Belgium (ongoing, recruitment ended), Germany (ended), Italy (ended), France (ongoing, recruitment ended).
Therapeutic area(s): Diseases [C] - Neoplasms [C04]
Gender: Female, Male. Age: 0-17 years, 18-64 years, 65+ years. Enrolment: 53.
Start date (EU): 2021-04-27. Decision date: 2024-06-13. Results received: No. Last updated: 2025-12-11.
Decision dates by country: BE: 2024-06-13, DE: 2024-06-13, IT: 2024-06-17, FR: 2024-07-09

Condition(s): Previously treated unresectable or metastatic BRAFV600 or NRAS mutant melanoma
Product: LEE011, LEE011, LTT462, LXH254, LXH254, TMT212, LXH254, LTT462, LXH254

Primary endpoint: Confirmed ORR using RECIST v1.1, per local assessment
Endpoint(s): Safety: Incidence and severity of adverse events (AEs) and serious adverse events (SAEs) including changes in laboratory values, vital signs and cardiac assessment, Tolerability: Dose interruptions, reductions, and permanent discontinuations of study treatments, DoR, PFS and DCR using RECIST v1.1, per local assessment, DoR, PFS, DCR and ORR, assessed using RECIST v1.1, per central assessment for all participants (selection and expansion) for the combination arms that moved to expansion, Overall survival (OS), Serum/plasma concentration and pharmacokinetic parameters of each combination regimen

Source: https://euclinicaltrials.eu/ctis-public/view/2024-511934-11-00